EU clinical trial 2024-512417-41-00: A Randomized, Double-blind, Parallel-group, Active-controlled Study to Compare the Efficacy, Pharmacokinetics, Pharmacodynamics, Safety, and Immunogenicity of MAB-22 Versus Prolia® Sourced from the European Union in Postmenopausal Women with Osteoporosis
Protocol code: MAB-22-301
Sponsor: Xentria Inc. (Pharmaceutical company). Phase: Therapeutic confirmatory (Phase III). Countries: Czechia (ended), Bulgaria (ended), Poland (ended).
Therapeutic area(s): Diseases [C] - Musculoskeletal Diseases [C05]
Gender: Female. Age: 18-64 years, 65+ years. Enrolment: 440.
Status: Ended. End date (EU): 2025-11-11. Decision date: 2024-09-25. Results received: No. Last updated: 2024-09-30.
Decision dates by country: BG: 2024-09-30, CZ: 2024-09-25, PL: 2024-09-30

Condition(s): Osteoporosis
Product: MAB-22, Prolia 60 mg solution for injection in pre-filled syringe, Prolia 60 mg solution for injection in pre-filled syringe, Prolia 60 mg solution for injection in pre-filled syringe

Primary endpoint: Efficacy coprimary endpoint: percentage change from baseline (%CfB) in lumbar spine BMD (LS BMD) at Week 52., PD coprimary endpoint: area under the effect curve (AUEC) of sCTX over the initial 6 month period (Day 1 to Week 26 [predose]).
Endpoint(s): Secondary Efficacy Endpoints: Percentage change from baseline in LS BMD at Weeks 26 and 78., Percentage change from baseline in total hip BMD (TH-BMD) and femoral neck BMD (FM-BMD) at Weeks 26, 52, and 78., Secondary PD Endpoints: Percentage change from baseline in sCTX and procollagen type 1 N-terminal propeptide (P1NP) at Weeks 26 and 52., Maximum percentage change from baseline in sCTX at Week 26., AUEC of P1NP over the initial 6-month period (from Day 1 to Week 26 [predose])., Secondary PK Endpoints: Maximum observed serum concentration (Cmax) of denosumab after the first administration (over the initial 6 month period [from Day 1 to Week 26 (predose)])., Trough serum concentration (Ctrough) of denosumab, predose and at Weeks 26, 52, and 78., Secondary Safety Endpoints: The safety and tolerability profile of participants will be assessed by the following parameters up to Weeks 52 and 78, and additionally through the whole study period for adverse events (AEs): Rate of AEs, serious adverse events (SAEs), and adverse reactions., Changes in safety clinical laboratory tests (hematology, chemistry, coagulation, and urinalysis [routine and microscopic])., Changes in vital signs, 12-lead electrocardiogram (ECG), and physical examination findings., Secondary Immunogenicity Endpoint: The rate of positive antidrug antibody (ADA) (the rate of positive neutralizing antibodies [NAbs] may be analyzed) up to Weeks 26, 52, and 78.

Source: https://euclinicaltrials.eu/ctis-public/view/2024-512417-41-00